EU clinical trial 2024-512743-23-00: C4951002 Phase 3, multicenter, randomized, double-blind, group sequential, placebo-controlled study to assess efficacy and safety of rimegepant for the treatment of migraine (with or without aura) in children and adolescents ≥ 6 to < 18 years of age
Protocol code: C4951002
Sponsor: Pfizer Inc. (Pharmaceutical company). Phase: Therapeutic confirmatory (Phase III). Countries: Sweden (ongoing, recruiting), Poland (ongoing, recruiting), Spain (ongoing, recruiting).
Therapeutic area(s): Diseases [C] - Nervous System Diseases [C10]
Gender: Female, Male. Age: 0-17 years. Enrolment: 155.
Status: Ongoing, recruiting. Start date (EU): 2021-08-31. Decision date: 2024-07-05. Results received: No. Last updated: 2026-02-03.
Decision dates by country: ES: 2024-07-05, PL: 2024-07-24, SE: 2024-07-08

Condition(s): Acute Migraine (with or without aura)
Product: VYDURA 75 mg oral lyophilisate, 35 mg oral lyophilisate, Placebo for 75 mg Rimegepant, Placebo for 50 mg rimegepant, 50 mg oral lyophilisate, Placebo for 35 mg rimegepant, Placebo for 25 mg Rimegepant, 25 mg oral lyophilisate

Primary endpoint: Pain freedom will be assessed using the number and percentage of participants that report no pain at 2 hours post double-blind treatment dose measured on a 4-point numeric rating scale (0=none, 1=mild, 2=moderate, 3=severe) in adolescent population (12 to less than 18 years of age).
Endpoint(s): Pain freedom will be assessed using the number and percentage of participants that report no pain at 2 hours post double-blind treatment dose in the combined population of children and adolescents 6 to less than 18 years of age). Participants with no pain are those who report 0 on the 4-point numeric scale in adolescents and who report Face 1 on the 5-Face visual analogue scales (VAS), in children., Freedom from the MBS associated with migraine will be assessed using the number and percentage of participants that report the absence of their MBS at 2 hours post double-blind treatment dose in the adolescent population. The MBS nausea, phonophobia or photophobia) will be measured using a binary scale (0=absent, 1=present)., The probabilities of requiring rescue medication will be assessed using the number and percentage of participants that take rescue medication within 24 hours and within 48 hours after administration of double-blind treatment (rimegepant or placebo) in the adolescent population., Sustained pain freedom, from 2 to 24 hours post double-blind treatment dose, will be assessed using the number and percentage of participants that do not use any rescue medications, and do not experience any headache pain through the time period of interest, in the adolescent population., Sustained pain freedom, from 2 to 48 hours post double-blind treatment dose, will be assessed using the number and percentage of participants that do not use any rescue medications, and do not experience any headache pain through the time period of interest, in the adolescent population., The proportion of participants able to function normally, at 2 hours post double-blind treatment dose, will be assessed using the number and percentage of participants that self-report as “normal” on the Functional Disability scale, in the adolescent population., Pain freedom will be assessed using the number and percentage of participants that report no pain (Face 1) at 2 hours post double-blind treatment dose, measured by a 5-Face VAS (Face 5 = ‘severe pain’, Faces 4 and 3 = ‘moderate pain’, Face 2 = ‘mild pain’, Face 1 = ‘no pain’) in the children population (6 to less than 12 years of age)., Freedom from the most bothersome symptom (MBS) associated with migraine will be assessed using the number and percentage of participants that report the absence of their MBS at 2 hours post double-blind treatment dose in children and in the combined population of children and adolescents. The MBS (nausea, phonophobia or photophobia) will be measured using a binary scale (0=absent, 1=present)., The probabilities of requiring rescue medication will be assessed using the numbers and percentage of participants that take rescue medication within 24 hours and within 48 hours after administration of double-blind study intervention (rimegepant or placebo) in children and in the combined population of children and adolescents., Sustained pain freedom, from 2 to 24 hours post double-blind treatment dose, will be assessed using the number and percentage of participants that do not use any rescue medications, and do not experience any headache pain through the time period of interest in children and in the combined population of children and adolescents., Sustained pain freedom, from 2 to 48 hours post double-blind treatment dose, will be assessed using the number and percentage of participants that do not use any rescue medications, and do not experience any headache pain through the time period of interest, in children and in the combined population of children and adolescents., Freedom from photophobia will be assessed by tabulating the number and percentage of participants that report the absence of photophobia at 2 hours post double-blind treatment dose in the subset of participants that reported the presence of photophobia at headache baseline, in adolescents, children, and the combined population of children and adolescents., Freedom from phonophobia will be assessed by tabulating the number and percentage of participants that report the absence of phonophobia at 2 hours post double-blind treatment dose in the subset of participants that reported the presence of phonophobia at headache baseline, in adolescents, children, and the combined population of children and adolescents., Freedom from nausea will be assessed by tabulating the number and percentage of participants that report the absence of nausea at 2 hours post double-blind treatment dose in the subset of participants that reported the presence of nausea at headache baseline, in adolescents, children, and the combined population of children and adolescents., Pain relief at 2 hours post double-blind treatment dose, will be assessed using the number and percentage of participants that report a pain level of moderate or severe at baseline and then report a pain level of none or mild at 2 hours post double-blind treatment dose in adolescents, children, and the combined population of children and adolescents., Time to first report of pain relief will be based on the first time point a participant reports a pain level of none or mild post double-blind treatment dose in adolescents, children, and the combined population of children and adolescents.

Source: https://euclinicaltrials.eu/ctis-public/view/2024-512743-23-00